EU clinical trial 2023-507129-40-00: CONQUEST Platform Clinical Study for Conquering Scleroderma: A Multicenter, Double-Blind, Randomized, Placebo-Controlled, Phase 2b Platform Clinical Study to Evaluate the Safety and Efficacy of Investigational Products in Participants with Interstitial Lung Disease Secondary to Systemic Sclerosis
Protocol code: SRF201
Sponsor: Scleroderma Research Foundation (Laboratory/Research/Testing facility). Phase: Therapeutic exploratory (Phase II). Countries: Poland (ongoing, recruiting), Germany (ongoing, recruiting), Spain (ongoing, recruiting), Norway (ongoing, recruiting), Netherlands (ongoing, recruiting), Denmark (ended), Italy (not authorised), France (ongoing, recruiting), Belgium (ongoing, recruiting), Portugal (ongoing, recruiting), Austria (ongoing, recruiting).
Therapeutic area(s): Diseases [C] - Respiratory Tract Diseases [C08]; Diseases [C] - Immune System Diseases [C20]
Gender: Female, Male. Age: 18-64 years, 65+ years. Enrolment: 81.
Start date (EU): 2024-08-06. Decision date: 2024-07-22. Results received: No. Last updated: 2026-07-31.
Decision dates by country: IT: 2024-07-29, PT: 2024-09-27, PL: 2024-07-29, DK: 2024-07-30, BE: 2024-09-24, AT: 2024-10-20, DE: 2024-07-26, ES: 2024-07-23, FR: 2024-08-23, NO: 2024-07-26, NL: 2024-07-30

Condition(s): interstitial lung disease secondary to systemic sclerosis (SSc-ILD)
Product: BI 1015550, BI 1015550-matching placebo, Amlitelimab, Amlitelimab-matching placebo

Primary endpoint: The change in Forced Vital Capacity (FVC, in mL), assessed from Baseline to the end of the treatment period at Week 52.
Endpoint(s): The change in HRCT QILD-WL from Baseline to the end of the treatment period at Week 52;, The change in FACIT-Dyspnea score from Baseline to the end of the treatment period at Week 52;, The proportion of study participants with an improvement in the revised CRISS score at Week 52, in study participants with diffuse cutaneous SSc and Baseline mRSS ≥10., SUBPROTOCOL A: - The absolute change in mRSS from baseline to Week 52 in participants with diffuse cutaneous SSc and baseline mRSS ≥10; and - The absolute change in HAQ-DI, assessed with SHAQ, from baseline to Week 52, SUBPROTOCOL B: - Change from Baseline in mRSS at Week 52 in study participants with diffuse cutaneous SSc and baseline mRSS ≥10; - Achievement of disease improvement at Week 52, defined by Revised CRISS criteria in study participants with diffuse cutaneous SSc and baseline mRSS ≥10 (≥25% relative improvement [≥5% improvement for FVC percent predicted] from Baseline at Week 52 on at least 2 of the 5 core set measures, without worsening on more than 1 measure).

Source: https://euclinicaltrials.eu/ctis-public/view/2023-507129-40-00